EU clinical trial 2024-511244-12-01: A prospective, multicenter, randomised, double-blind, placebo-controlled, parallel groups, phase 3 Trial to compare the efficacy and safety of masitinib in combination with standard of care versus placebo in combination with standard of care in the treatment of patients suffering from Amyotrophic Lateral Sclerosis (ALS)
Protocol code: AB23005
Sponsor: Ab Science (Pharmaceutical company). Phase: Therapeutic confirmatory (Phase III). Countries: Spain (suspended), Slovenia (suspended), Greece (suspended), Sweden (not authorised), France (not authorised), Latvia (suspended), Germany (suspended).
Therapeutic area(s): Diseases [C] - Nervous System Diseases [C10]
Gender: Female, Male. Age: 18-64 years, 65+ years. Enrolment: 135.
Decision date: 2025-06-13. Results received: No. Last updated: 2025-11-11.
Decision dates by country: DE: 2025-11-11, LV: 2025-11-07, FR: 2025-06-13, GR: 2025-07-04, SE: 2025-06-24, SI: 2025-07-02, ES: 2025-06-25

Condition(s): Amyotrophic Lateral Sclerosis
Product: RILUTEK 50 mg film-coated tablets, masitinib, Placebo to 200mg masitinib, masitinib, Riluzole Zentiva 50 mg film-coated tablets, Placebo to 100mg masitinib

Primary endpoint: The primary analysis will be done in the ITT population. Absolute change from baseline at week 48 in ALSFRS-R score will be analysed using multiple imputation model.
Endpoint(s): • PFS analysed using the log rank test. Kaplan-Meier Plots, • ALSAQ-40 change analyzed using the same model as primary, • FVC change from baseline analysed using the same model as primary, • Upper- and lower-limb muscle strength using HHD summarized by treatment arm, • Clinician-rated CGI summarized by treatment arm, • CAFS analysed using the Generalised GehanWilcoxon rank test, • OS analysed using the log rank test. Kaplan-Meier Plots, • TFS analysed using the Gehan-Wilcoxon test and the log rank test. Kaplan-Meier Plots, • Safety: Occurrence of Adverse Events (AE), changes on physical examination, vital signs (blood pressure, heart rate, weight and temperature), ECG and clinical laboratory tests (haematology, biochemistry, urinalysis, urinary cytology), • Identification of pharmacodynamic biomarker(s), • Measurement of pharmacokinetic parameters of Masitinib

Source: https://euclinicaltrials.eu/ctis-public/view/2024-511244-12-01